EU clinical trial 2024-518218-24-00: A double-blind, randomized, controlled trial on the effect of PEX010 for prolonged grief disorder
Sponsor: Linkopings Universitet (Educational Institution). Phase: Therapeutic exploratory (Phase II). Countries: Sweden (ongoing, recruiting).
Therapeutic area(s): Psychiatry and Psychology [F] - Mental Disorders [F03]
Gender: Female, Male. Age: 18-64 years, 65+ years. Enrolment: 60.
Status: Ongoing, recruiting. Start date (EU): 2025-07-17. Decision date: 2025-02-10. Results received: No. Last updated: 2026-07-17.

Condition(s): Prolonged grief disorder
Product: PEX010 Psilocybin Capsules (1mg psilocybin), PEX010 Psilocybin Capsules (25 mg psilocybin)

Primary endpoint: Score on PG13-R
Endpoint(s): Score on PG13-R

Source: https://euclinicaltrials.eu/ctis-public/view/2024-518218-24-00